EU clinical trial 2024-519782-21-00: A randomized controlled study to assess the efficacy of topical Sinecathechins used as adjuvant therapy to topical ablative trichloroacetic acid in the Treatment of anal High grade squamous intraepithelial lesion
Protocol code: SINECHSIL
Sponsor: Fundacio Hospital Universitari Vall D’Hebron Institut De Recerca (Laboratory/Research/Testing facility). Phase: Therapeutic use (Phase IV). Countries: Spain (ongoing, recruiting).
Therapeutic area(s): Diseases [C] - Digestive System Diseases [C06]
Gender: Female, Male. Age: 18-64 years, 65+ years. Enrolment: 150.
Status: Ongoing, recruiting. Start date (EU): 2025-09-18. Decision date: 2025-03-24. Results received: No. Last updated: 2025-08-21.

Condition(s): Anal high-grade squamous intraepithelial lesions (HSIL).
Product: SINECATECHINS

Primary endpoint: Cumulative proportion of patients free of HSIL at 48 weeks post-treatment (with an allowed deviation of 8 weeks).

Source: https://euclinicaltrials.eu/ctis-public/view/2024-519782-21-00